EU clinical trial 2024-517151-12-00: Improving diagnostics in cervical dysplasia
Sponsor: Region Midtjylland (Hospital/Clinic/Other health care facility). Phase: Therapeutic use (Phase IV). Countries: Denmark (ongoing, recruiting).
Therapeutic area(s): Analytical, Diagnostic and Therapeutic Techniques and Equipment [E] - Diagnosis [E01]; Diseases [C] - Female Urogenital Diseases and Pregnancy Complications [C13]
Gender: Female. Age: 18-64 years, 65+ years. Enrolment: 150.
Status: Ongoing, recruiting. Start date (EU): 2024-09-01. Decision date: 2024-08-29. Results received: No. Last updated: 2026-01-05.

Condition(s): Patients are either or both HPV positive and has cervical cell changes/dysplasia.
Product: Placebo til vagifem vaginal tablet 10 mikrogram., Vagifem 10 mikrogram vaginaltabletter

Primary endpoint: Between groups, primary outcomes will be: • Scoring of the visibility of the SCJ by the colposcopist as TZ1, TZ2 and TZ3. • Representation of the TZ in at least 25% of the cervical biopsies from each patient described by the pathologist.
Endpoint(s): Between groups, secondary outcomes will be: • The patients' report on possible side effects during pretreatment. • The proportionen of CIN2+ found in biopsies. • The proportion of diagnostics conization. • Explore for each patient which biopsy represent the most severe histopathologic result by comparing the first biopsy with the other three.

Source: https://euclinicaltrials.eu/ctis-public/view/2024-517151-12-00